EU clinical trial 2023-505818-16-00: A Multicentric Randomized Double-Blind Phase 3 Trial Evaluating the Efficacy of an Adapted Antibiotherapy in Hurley Stage 2 Active Hidradenitis Suppurativa Patients versus Tetracycline Derivative (ABCESS2)
Protocol code: 2018-018
Sponsor: Institut Pasteur (Educational Institution). Phase: Therapeutic confirmatory (Phase III). Countries: France (ongoing, recruiting).
Therapeutic area(s): Diseases [C] - Skin and Connective Tissue Diseases [C17]
Gender: Female, Male. Age: 18-64 years. Enrolment: 92.
Status: Ongoing, recruiting. Start date (EU): 2025-05-22. Decision date: 2023-07-31. Results received: No. Last updated: 2026-05-05.

Condition(s): Hurley stage 2 active Hidradenitis Suppurativa
Product: Avalox® 400 mg Filmtabletten, PL1 : ROCEPHINE 1 g/3,5 ml, poudre et solvant pour solution injectable (IM), RIFADINE 300 mg, gélule, MOXIFLOXACINE SANDOZ 400 mg, comprimé pelliculé, TETRALYSAL 150 mg, gélule, MOXIFLOXACINE SANDOZ 400 mg, comprimé pelliculé, PL3 : capsule for oral use composed of riboflavin, microcrystalline cellulose, N2 capsule , DBCaps size A capsule, PL2 : caspule for oral use composed of cornstarch, colloidal anhydrous silica, cochineal carmine, dbcaps size aa elongated capsule, IZILOX 400 mg, comprimé pelliculé, PL4 : capsule for oral use composed of microcrystalline cellulose, DBCaps size AA capsule, PL5 : capsule for oral use composed of microcrystalline cellulose, N2 capsule , DBCaps size A capsule, FLAGYL 250 mg, comprimé pelliculé, ROCEPHINE 1 g/3,5 ml, poudre et solvant pour solution injectable (IM)

Primary endpoint: Percentage of patients reaching clinical remission at week 12, defined by an improvement of 90% of the IHS4 score from the baseline (IHS4)
Endpoint(s): Efficacy: Physician HS evaluation: Physician Global Assessment (PGA), modified Sartorius score, HS clinical Response (HiSCR), International Hidradenitis Suppurativa Severity Score (IHS4) at each visit, Efficacy: Normalization of the worst lesion microbiome at W12 compared to baseline at inclusion, Efficacy: Patient's HS evaluation: Pain (visual analogic scale, number of painful days per month); Dermatology Life Quality Index (DLQI), Efficacy: Number of pain killers and antibiotic treatments prescribed for flares (acute worsening of one or more HS lesions), number of surgical drainages, Efficacy : Time without flare of HS after remission, number of flares using a patient journal, Efficacy: Identification of prognosis markers of response to treatments, Safety: Description of adverse events related to treatments, Safety: Description of adverse events related to protocol procedures other than treatments, Safety: Emergence of extended spectrum betalactamase and carbapenemase producing enterobacteriaceae as well as vancomycin resistant enterococci in the gut microflora

Source: https://euclinicaltrials.eu/ctis-public/view/2023-505818-16-00